EU clinical trial 2023-508218-41-00: A Phase 3b Multicenter Open-label Trial of the Safety, Tolerability, and Efficacy of Tolvaptan in Infants and Children 28 days to less than 18 years of Age with Autosomal Recessive Polycystic Kidney Disease (ARPKD).
Protocol code: 156-201-00307
Sponsor: Otsuka Pharmaceutical Development & Commercialization Inc. (Pharmaceutical company). Phase: Therapeutic confirmatory (Phase III). Countries: Belgium (ongoing, recruiting), Spain (ongoing, recruiting), Germany (authorised, recruitment pending), Poland (ended).
Therapeutic area(s): Diseases [C] - Congenital, Hereditary, and Neonatal Diseases and Abnormalities [C16]
Gender: Female, Male. Age: 0-17 years. Enrolment: 13.
Start date (EU): 2023-08-17. Decision date: 2024-05-06. Results received: No. Last updated: 2026-07-29.
Decision dates by country: PL: 2024-05-07, BE: 2024-05-08, ES: 2024-05-06, DE: 2024-05-14

Condition(s): Autosomal Recessive Polycystic Kidney Disease
Product: Jinarc 15 mg tablets, Samsca 7.5 mg tablets, Jinarc 30 mg tablets, Tolvaptan

Primary endpoint: Safety assessments which will be summarized by descriptive statistics, and the endpoints will be • Adverse events • Vital signs • Clinical laboratory assessments, Serum transaminase elevations for frequency (2 ×, 3 ×, 5 × and 10 × ULN), time to onset, time to peak levels, time of offset (< 3 ×, 2 ×, or 1 × ULN), response to de challenge and re-challenge and frequency of progression to Hy’s laboratory criteria (ALT or AST > 3 × ULN and BT, > 2 × ULN without alkaline phosphatase ≥2 × ULN) • Change from baseline in sNa+
Endpoint(s): Annual rate of change of eGFR (eGFR Schwartz formula = 0.413 × height [or length, cm] /serum creatinine mg/dL) from baseline to post‑treatment after 18 months of treatment., Change from baseline of eGFR (eGFR Schwartz formula = 0.413 × height [or length, cm] /serum creatinine mg/dL) while on treatment at Months 1, 6, 12, and 18., Time to RRT, Percentage of subjects who receive RRT, Percentage of change in kidney size of height adjusted TKV at every time point from baseline to 18 months on treatment via ultrasound using ellipsoid methodology., Change from baseline (last assessment prior to dosing) in growth percentile trajectories for height (stature), weight, and head circumference (for subjects ≤ 2 years or age) at 3 months, 6 months, 12 months, and 18 months., Age-appropriate assessment of palatability and acceptability of suspension formulation for applicable subjects., Proportions of each Tanner Staging by gender and age at baseline and every 6 months until Month 18/EoTx.

Source: https://euclinicaltrials.eu/ctis-public/view/2023-508218-41-00